EU clinical trial 2024-514133-38-00: A Randomized, Double-Blinded, Placebo-Controlled, Phase 3, Parallel-Group Design Study Evaluating the Efficacy and Safety of Efgartigimod PH20 SC Administered by Prefilled Syringe in Adult Participants With Ocular Myasthenia Gravis
Protocol code: ARGX-113-2315
Sponsor: Argenx (Pharmaceutical company). Phase: Therapeutic confirmatory (Phase III). Countries: Spain (ongoing, recruitment ended), Cyprus (ended), Netherlands (ongoing, recruitment ended), Czechia (ongoing, recruitment ended), Poland (ongoing, recruitment ended), Austria (ongoing, recruitment ended), Greece (ongoing, recruitment ended), Finland (ended), France (ongoing, recruitment ended), Denmark (ongoing, recruitment ended), Sweden (ended), Belgium (ongoing, recruitment ended), Italy (ongoing, recruitment ended), Germany (ongoing, recruitment ended), Portugal (ended).
Therapeutic area(s): Diseases [C] - Immune System Diseases [C20]
Gender: Female, Male. Age: 18-64 years, 65+ years. Enrolment: 169.
Start date (EU): 2025-03-19. Decision date: 2025-03-04. Results received: No. Last updated: 2026-03-17.
Decision dates by country: FI: 2025-03-17, DE: 2025-03-04, PT: 2025-03-05, BE: 2025-03-04, CY: 2025-03-06, AT: 2025-03-10, SE: 2025-03-14, DK: 2025-03-18, NL: 2025-03-10, IT: 2025-03-17, ES: 2025-03-04, CZ: 2025-03-05, GR: 2025-03-06, FR: 2025-03-10, PL: 2025-03-09

Condition(s): Ocular Myasthenia Gravis
Product: Vyvgart 1 000 mg solution for injection in pre-filled syringe, Placebo PH20 SC

Primary endpoint: MGII (PRO) ocular score change from baseline to day 29 in part A
Endpoint(s): • MGII (PRO+PE) ocular score change from baseline to day 29 in part A, • MG-ADL ocular domain score change from baseline to day 29 in part A, • MGII total score change from baseline to day 29 in part A, • MGII (PE) ocular score change from baseline to day 29 in part A, • MG-ADL total score change from baseline to day 29 in part A, • MGII ocular scores (PRO, PRO+PE, and PE), generalized score, and total score; actual values and changes from baseline in part A and part A+B, • Incidence and severity of AEs and SAEs in part A and part A+B, • Clinically relevant changes in laboratory parameters, vital signs, and ECGs in part A and part A+B, • MG-QoL15r total score actual values and changes from baseline in part A and part A+B, • NEI VFQ-25 score actual values and changes from baseline in part A and part A+B, • Actual values and percent changes from baseline in total IgG levels over time in part A and part A+B, Actual values and percent change from baseline in AChR-Ab levels in AChR-Ab seropositive participants over time in part A and part A+B, • Incidence and prevalence of Anti-Drug Antibodies and Neutralizing Antibodies against efgartigimod in part A and part A+B, • Incidence and prevalence of antibodies and Neutralizing Antibodies against rHuPH20 in part A and part A+B

Source: https://euclinicaltrials.eu/ctis-public/view/2024-514133-38-00